EU clinical trial 2023-510289-28-00: A Phase 2, Open-label, Multicenter Study of Mitapivat in Subjects With Sickle Cell Disease and Nephropathy
Protocol code: AG348-C-026
Sponsor: Agios Pharmaceuticals Inc. (Pharmaceutical company). Phase: Therapeutic exploratory (Phase II). Countries: France (ended), Ireland (ended).
Therapeutic area(s): Diseases [C] - Hemic and Lymphatic Diseases [C15]
Gender: Female, Male. Age: 0-17 years, 18-64 years, 65+ years. Enrolment: 17.
Status: Ended. End date (EU): 2026-02-12. End date: 2026-02-13. Decision date: 2024-10-07. Results received: No. Last updated: 2026-01-26.
Decision dates by country: FR: 2024-10-07, IE: 2024-10-11

Condition(s): Sickle Cell Disease (SCD) and Nephropathy
Product: MITAPIVAT

Primary endpoint: ACR response, defined as a ≥30% decrease in ACR from baseline to Month 6
Endpoint(s): 1. Change from baseline in eGFRcr-cys 2. Change from baseline in ACR 3. Stable ACR, defined as Month 6 ACR within ±20% of baseline ACR 4. Annualized rate of visits to emergency room (ER) 5. Annualized rate of days of hospitalizations 6. Type, frequency and severity of AEs and SAEs and relationship to study drug

Source: https://euclinicaltrials.eu/ctis-public/view/2023-510289-28-00